EU clinical trial 2023-507348-35-00: Anti-viral action against Type 1 diabetes autoimmunity GPPAD-05-AVAnT1A
Sponsor: Klinikum rechts der Isar der TU Muenchen AöR (Hospital/Clinic/Other health care facility). Phase: Therapeutic use (Phase IV). Countries: Poland (not authorised), Sweden (ongoing, recruiting), Belgium (ongoing, recruiting), Germany (ongoing, recruiting), Austria (ongoing, recruiting), Italy (authorised, recruitment pending).
Therapeutic area(s): Health Care [N] - Environment and Public Health [N06]; Diseases [C] - Virus Diseases [C02]; Diseases [C] - Nutritional and Metabolic Diseases [C18]; Diseases [C] - Immune System Diseases [C20]
Gender: Female, Male. Age: 0-17 years. Enrolment: 2365.
Start date (EU): 2024-05-30. Decision date: 2024-04-11. Results received: No. Last updated: 2026-03-09.
Decision dates by country: SE: 2024-04-11, PL: 2024-04-15, BE: 2024-04-11, AT: 2025-07-24, IT: 2026-02-23, DE: 2024-04-15

Condition(s): Risk for Type 1 Diabetes
Product: Comirnaty Omicron XBB.1.5 3 micrograms/dose concentrate for dispersion for injection COVID-19 mRNA Vaccine (nucleoside modified), Comirnaty Omicron XBB.1.5 3 micrograms/dose concentrate for dispersion for injection COVID-19 mRNA Vaccine (nucleoside modified), Comirnaty Omicron XBB.1.5 3 micrograms/dose concentrate for dispersion for injection COVID-19 mRNA Vaccine (nucleoside modified), Comirnaty Omicron XBB.1.5 3 micrograms/dose concentrate for dispersion for injection COVID-19 mRNA Vaccine (nucleoside modified), 0.9% Sodium Chloride solution for injection (saline)

Primary endpoint: The primary efficacy outcome is the elapsed time from random treatment assignment to the development of persistent confirmed islet autoantibod-ies or type 1 diabetes
Endpoint(s): The elapsed time from random treatment assignment to the development of per-sistent confirmed multiple islet autoan-tibodies; the development of type 1 diabetes; the development of persistent con-firmed transglutaminase autoantibodies

Source: https://euclinicaltrials.eu/ctis-public/view/2023-507348-35-00